EU clinical trial 2023-504468-41-00: Bioequivalence of Eltrombopag 25 mg Film-Coated Tablets in Healthy Subjects Under Fasting Conditions.
Protocol code: BLCL-ELT-EU-02
Sponsor: Bluepharma Industria Farmaceutica S.A. (Pharmaceutical company). Phase: Human Pharmacology (Phase I)- Bioequivalence Study. Countries: Portugal (ended).
Therapeutic area(s): Not possible to specify
Gender: Female, Male. Age: 18-64 years. Enrolment: 42.
Status: Ended. End date (EU): 2025-08-08. Decision date: 2023-08-08. Results received: No. Last updated: 2024-02-09.

Condition(s): No medical condition

Source: https://euclinicaltrials.eu/ctis-public/view/2023-504468-41-00